EU clinical trial 2025-523503-30-00: A Randomized, Double-Blind, Placebo-Controlled Trial to Evaluate the Efficacy and Safety of E2086 in Adults with Narcolepsy
Protocol code: E2086-G000-202
Sponsor: Eisai Limited (Pharmaceutical company). Phase: Therapeutic exploratory (Phase II). Countries: Belgium (authorised, recruitment pending), Italy (authorised, recruitment pending), Spain (authorised, recruitment pending), Germany (authorised, recruitment pending).
Therapeutic area(s): Diseases [C] - Nervous System Diseases [C10]
Gender: Female, Male. Age: 18-64 years, 65+ years. Enrolment: 51.
Status: Authorised, recruitment pending. Decision date: 2026-07-08. Results received: No. Last updated: 2026-07-16.
Decision dates by country: IT: 2026-07-08, ES: 2026-07-09, DE: 2026-07-08, BE: 2026-07-08

Condition(s): Narcolepsy
Product: Tablets that match the E2086 tablets in both shape and appearance., E2086, E2086, E2086, E2086, E2086

Primary endpoint: Change from Baseline to Week 4 in MSL for E2086 Compared With Placebo Across Four MWTs in Participants With NT1 and NT2
Endpoint(s): Weekly Cataplexy Rate (WCR) of E2086 Compared With Placebo at Week 4 in Participants With NT1, Change From Baseline in the Epworth Sleepiness Scale (ESS) Total Score to Week 4 for E2086 Compared With Placebo in Participants With NT1 and NT2, Number of Participants With Treatment-emergent Adverse Events (TEAEs) and Serious Adverse Events (SAEs) in Participants With NT1 and NT2, Number of Participants With Markedly Abnormal Laboratory Values in Participants With NT1 and NT2, Number of Participants With Clinically Significant Changes in Vital Sign Values in Participants With NT1 and NT2, Number of Participants With Clinically Significant Changes in 12-Lead Electrocardiogram (ECG) Parameters in Participants With NT1 and NT2, Number of Participants With Suicidality as Assessed by Columbia - Suicide Severity Rating Scale (C-SSRS) in Participants With NT1 and NT2, Mean Change From Baseline in 24-hours Systolic Blood Pressure (SBP) and Diastolic Blood Pressure (DBP) up to Week 4 of each dose level in Participants With NT1 and NT2, Mean Change From Baseline in Day-time and Night-time BP Measured by ABPM in Participants With NT1 and NT2, Cmax: Maximum Observed Plasma Concentration of E2086 and its Metabolite M1, Tmax: Time to Reach Cmax of E2086 and its Metabolite M1, AUC(0-24h): Area Under the Plasma Concentration–time Curve From Zero Time to 24 Hours of E2086 and its Metabolite M1, t½: Terminal Phase Half-life of E2086 and its Metabolite M1, MRp: Metabolite Ratio of AUC(0-t)

Source: https://euclinicaltrials.eu/ctis-public/view/2025-523503-30-00